EU clinical trial 2022-502810-10-00: A Phase 2, Randomized, Double-Blind, Placebo-Controlled, Efficacyand Safety Study Of Daxdilimab Subcutaneous Injection In Adult Participants With Inadequately Controlled Dermatomyositis Or Anti-Synthetase Inflammatory Myositis
Protocol code: HZNP-DAX-205
Sponsor: Horizon Therapeutics Ireland Designated Activity Company (Pharmaceutical company). Phase: Therapeutic exploratory (Phase II). Countries: Spain (ended), Italy (ended), Germany (ended), Czechia (ended), France (ended).
Therapeutic area(s): Diseases [C] - Immune System Diseases [C20]; Diseases [C] - Skin and Connective Tissue Diseases [C17]
Gender: Female, Male. Age: 18-64 years, 65+ years. Enrolment: 26.
Status: Ended. Start date (EU): 2023-09-12. End date (EU): 2024-08-07. End date: 2025-07-02. Decision date: 2023-07-24. Results received: Yes. Last updated: 2025-03-11.
Decision dates by country: CZ: 2023-07-28, ES: 2023-07-24, DE: 2023-07-27, FR: 2023-07-31, IT: 2023-07-27

Condition(s): Dermatomyositis (DM) or anti-synthetase inflammatory myositis (ASIM)
Product: Daxdilimab, Prednison Léčiva 20 mg tablety, Prednisona Alonga 10 mg comprimidos, Prednison acis 20 mg, CORTANCYL 20 mg, comprimé sécable, Nominal 1 mL of 20 mM L-histidine/L-histidine HCl, 240 mM sucrose, 0.02% (w/v) polysorbate 80, pH 6.0, CORTIREX 20 mg compresse

Primary endpoint: TIS (Total improvement score) at Week 24.
Endpoint(s): Proportion of participants with improvement of TIS ≥ 40 and without deterioration at 2 consecutive visits at 24 weeks. Proportion of participants with improvement of TIS ≥ 20 and without deterioration at 2 consecutive visits at 24 weeks, Change in the CDASI activity score from Baseline (Day 1) to Week 24, Proportion of participants on an OCS dose ≥ 10 mg of prednisone or equivalent at Baseline who achieve a clinically meaningful reduction in the OCS dose: either a 25% decrease or an OCS dose of 7.5 mg/day of prednisone or equivalent at Week 24, Serum concentration of daxdilimab (DAX) over time. Prevalence at Baseline and incidence and titer of antidrug antibodies directed against dax over time., Incidence of TEAEs Incidence of TESAEs Incidence of TEAESIs: hypersensitivity reaction, including anaphylaxis, herpes zoster infection, severe (CTCAE Grade 3 or higher) viral infection/reactivation, opportunistic infection, and malignancy (except non-melanoma skin cancer).

Source: https://euclinicaltrials.eu/ctis-public/view/2022-502810-10-00